EU clinical trial 2024-514333-37-00: A Phase II, Multi-centre, Open label, Randomised Study to Evaluate the Anti-tumour Activity of Roginolisib (IOA-244) in Patients with Advanced/Metastatic Ocular/Uveal Melanoma
Protocol code: IOA-244-201
Sponsor: iOnctura SA (Pharmaceutical company). Phase: Therapeutic exploratory (Phase II). Countries: Italy (ongoing, recruiting), Spain (ongoing, recruiting).
Therapeutic area(s): Diseases [C] - Eye Diseases [C11]
Gender: Female, Male. Age: 18-64 years, 65+ years. Enrolment: 43.
Status: Ongoing, recruiting. Start date (EU): 2025-02-25. Decision date: 2024-12-17. Results received: No. Last updated: 2026-07-21.
Decision dates by country: IT: 2024-12-19, ES: 2024-12-17

Condition(s): Advanced Metastatic Ocular/Uveal Melanoma
Product: YERVOY 5 mg/ml concentrate for solution for infusion, OPDIVO 10 mg/mL concentrate for solution for infusion., Opdualag 240 mg/80 mg concentrate for solution for infusion, IOA-244, Dacarbazine medac 500 mg, poudre pour solution pour perfusion, PEMBROLIZUMAB

Primary endpoint: OS is defined as the time from randomisation until death from any cause.
Endpoint(s): • PFS is defined as the time from the date of the first dose of IMP until the earliest date of disease progression as determined by radiographic/objective disease assessment as per RECIST v1.1 provided by the Investigators, or death from any cause; • ORR is defined percentage of patients with a Complete Response (CR) or Partial Response (PR) determined by Investigator based on appropriate radiographic imaging and consistent with RECIST v1.1, 1. (cont.)• DOR is defined as the time from the date of first documented response (CR, PR) by RECIST v1.1 until the date of documented progression or death in the absence of disease progression; • Time to Response is defined as the time from date of first dose of IMP until the date of first documented objective response, per RECIST v1.1 as assessed by Investigator;, 1 (cont)• DCR defined as the proportion of patients with a Best Objective Response (BOR) of CR or PR or SD recorded at ≥8 weeks (±1 week), prior to any progressive disease event; • CBR is defined as the proportion of patients with a BOR of CR or PR or SD recorded at C5D1; • Survival probability defined as the probability that an individual survives from date of first dose of IMP until 6 months, 9 months, 12 months and 24 months after end of treatment. Median survival time will also be estimated., 2. Safety and tolerability will be assessed by: • Evaluation of AEs during treatment and followup using National Cancer Institute (NCI) CTCAE v5.0; • Laboratory parameters; • Vital signs, physical examination, 12-lead electrocardiogram (ECG), Eastern Cooperative Oncology Group (ECOG) performance status;, 3. Concentration of roginolisib at pre-dose and steady state levels (including AUC, population PK);, 4. Changes in PRO relative to baseline using following questionnaires: • EQ-5D-5L; • European Organisation for Research Treatment of Cancer (EORTC) Quality of Life Questionnaires (QLQ)-C30; • Epworth Sleepiness Scale (ESS); • Fatigue Severity Scale (FSS)., 5. Safety and tolerability will be assessed by: • Evaluation of AEs during treatment and followup using NCI CTCAE v5.0; • Laboratory parameters; • Vital signs, physical examination, 12-lead ECG, ECOG performance status., 6. Assessed by health resource use (e.g., hospitalisations, outpatient visits, emergency visits, preparation and time for IMP administration, etc)

Source: https://euclinicaltrials.eu/ctis-public/view/2024-514333-37-00